EU clinical trial 2023-507721-41-00: A trial of prednisolone in combination with SPI-62 in participants with polymyalgia rheumatica (PMR)
Protocol code: SPI-62-CL-1002
Sponsor: Sparrow Pharmaceuticals Inc. (Pharmaceutical company). Phase: Human Pharmacology (Phase I)- Other. Countries: Germany (ended).
Therapeutic area(s): Diseases [C] - Musculoskeletal Diseases [C05]
Gender: Female, Male. Age: 18-64 years, 65+ years. Enrolment: 14.
Status: Ended. Start date (EU): 2024-03-11. End date (EU): 2024-12-03. Decision date: 2024-02-20. Results received: No. Last updated: 2024-04-19.
Decision dates by country: DE: 2024-04-19

Condition(s): polymyalgia rheumatica

Source: https://euclinicaltrials.eu/ctis-public/view/2023-507721-41-00